EU clinical trial 2025-523524-53-00: C6461008 - AN INTERVENTIONAL PHASE 1B/2 STUDY TO EVALUATE THE SAFETY AND EFFICACY OF PF-08634404 MONOTHERAPY AND IN COMBINATION WITH OTHER ANTICANCER AGENTS IN ADULT PARTICIPANTS WITH LOCALLY ADVANCED OR METASTATIC RENAL CELL CARCINOMA
Protocol code: C6461008
Sponsor: Pfizer Inc. (Pharmaceutical company). Phase: Phase I and Phase II (Integrated)- Other. Countries: Germany (authorised, recruitment pending), Spain (ongoing, recruiting).
Therapeutic area(s): Diseases [C] - Neoplasms [C04]
Gender: Female, Male. Age: 18-64 years, 65+ years. Enrolment: 50.
Start date (EU): 2026-06-12. Decision date: 2026-04-21. Results received: No. Last updated: 2026-07-17.
Decision dates by country: ES: 2026-04-21, DE: 2026-04-22

Condition(s): ADVANCED OR METASTATIC RENAL CELL CARCINOMA
Product: AXITINIB, PF-08634404, AXITINIB, IPILIMUMAB

Primary endpoint: Cohort A: Confirmed objective response rate (ORR) using Response Evaluation Criteria in Solid Tumors (RECIST) 1.1 as assessed by the investigator, Cohort A: Adverse events (AEs) as characterized by type, frequency, intensity as graded by National Cancer Institute Common Terminology Criteria for Adverse Events (NCI CTCAE) version 5.0, timing, seriousness, and relationship to study intervention(s), Cohort B/C: Dose limiting toxicities (DLTs) in the first cycle (Part 1), Cohort B/C: AEs as characterized by type, frequency, intensity as graded by NCI CTCAE version 5.0, timing, seriousness, and relationship to study intervention(s)., Cohort B/C: Confirmed ORR using RECIST 1.1 as assessed by investigator
Endpoint(s): Cohort A: - Duration of response (DoR) using RECIST 1.1 as assessed by investigator - Progression-free survival (PFS) using RECIST 1.1 as assessed by investigator - Overall survival (OS), Cohort A: Laboratory test abnormalities as characterized by type, frequency, severity (as graded by NCI CTCAE version 5.0) and timing, Cohort A: Predose and post dose concentrations of PF-08634404., Cohort A: Incidence of antidrug antibodies (ADA) against PF-08634404, Cohort B/C: - DoR using RECIST 1.1 as assessed by investigator - PFS using RECIST 1.1 as assessed by investigator - OS, Cohort B/C: Laboratory abnormalities as characterized by type, frequency, severity (as graded by NCI CTCAE version 5.0) and timing, Cohort B/C: Predose and post dose concentrations of PF-08634404, Cohort B/C: Incidence of ADA against PF-08634404

Source: https://euclinicaltrials.eu/ctis-public/view/2025-523524-53-00